EU clinical trial 2025-523273-41-00: A Phase 1/2 dose escalation trial with administration schedule exploration evaluating single agent TD001, a PSMA-targeted antibody-drug conjugate, in patients with PSMA-expressing metastatic castration-resistant prostate cancer
Protocol code: TD001-101
Sponsor: T.O.A.D. Oncology S.A. (Pharmaceutical company). Phase: Phase I and Phase II (Integrated)- First administration to humans. Countries: Spain (authorised, recruitment pending), France (ongoing, recruiting).
Therapeutic area(s): Diseases [C] - Neoplasms [C04]
Gender: Male. Age: 18-64 years, 65+ years. Enrolment: 110.
Start date (EU): 2026-01-30. Decision date: 2026-01-16. Results received: No. Last updated: 2026-01-21.
Decision dates by country: FR: 2026-01-16, ES: 2026-01-21

Condition(s): Metastatic castration-resistant prostate cancer
Product: TD001

Primary endpoint: Incidence and severity of DLTs during Cycle 1 (dose escalation only), Incidence, severity, and relationship of AEs and SAEs, Laboratory parameters, Treatment discontinuations and treatment modifications due to AEs
Endpoint(s): Plasma concentration profile parameters (AUC, AUClast, AUCtau, Cmax, Tmax, T1/2, and Ctrough) of total ADC, total antibody, and unconjugated exatecan payload, Safety and efficacy endpoints, PSA50 response rate, ORR by investigator assessment, PSA PFS, Radiographic PFS by investigator assessment, Duration of response (PSA and radiographic by investigator assessment), Disease control rate, Overall survival, Prevalence and plasma titers of ADA against TD001

Source: https://euclinicaltrials.eu/ctis-public/view/2025-523273-41-00